EU clinical trial 2024-513325-23-00: FIBRAPLO - Haplo-identical transplantation in patients with myleofibrosis : A phase 2 prospective multicentric prospective study
Protocol code: APHP190648
Sponsor: Assistance Publique Hopitaux De Paris (Hospital/Clinic/Other health care facility). Phase: Therapeutic exploratory (Phase II). Countries: France (ongoing, recruitment ended).
Therapeutic area(s): Diseases [C] - Neoplasms [C04]
Gender: Female, Male. Age: 18-64 years, 65+ years. Enrolment: 28.
Status: Ongoing, recruitment ended. Start date (EU): 2021-02-03. Decision date: 2024-07-23. Results received: No. Last updated: 2024-07-23.

Condition(s): Myelofibrosis
Product: Trecondi 1 g powder for solution for infusion, FLUDARABINE PHOSPHATE, THIOTEPA, Trecondi 5 g powder for solution for infusion

Primary endpoint: The main criteria of judgement is disease- and rejection-free survival 12 months after HSCT.
Endpoint(s): incidence of acute grade 2-4 and grade 3-4 GVHD according to the modified Glucksberg classification, incidence of chronic GVHD (limited vs extensive) at 12 months according to the revised Seattle criteria, neutrophil engraftment on day 60 post-transplantation, engraftment is defined as neutrophil count at 0.5G/L or higher for more than 3 consecutive days after transplantation, it should be confirmed by a donor chimerism, latelet recovery: first day of platelet > 20G/L without transfusion the last 7 days assessed on day 100, overall survival at 12 months, on-relapse mortality at 12 months, incidence of relapse/progression at 12 months, incidence of rejection at 12 months, infection incidence at 100 days, 12 months (annexe for infection), cytokine profile during transplantation (day-7 +/- 1 jour, J0 and day J7 +/- 1 jour ), impact of genetic alterations on overall survival at 12 months and non-relapse mortality at 12 months

Source: https://euclinicaltrials.eu/ctis-public/view/2024-513325-23-00